EU clinical trial 2024-513496-40-00: A randomized, double-blind, placebo-controlled, 104-week proof-of-concept study to evaluate the efficacy of intravenous prasinezumab in participants with Parkinson's disease carrying a severe mutation in the GBA gene (prevent cognitive decline in GBA-associated PD)
Protocol code: PreCoDe / BN45387
Sponsor: Universitaetsklinikum Tuebingen AöR (Hospital/Clinic/Other health care facility). Phase: Therapeutic exploratory (Phase II). Countries: Spain (authorised, recruitment pending), Germany (authorised, recruitment pending), Italy (authorised, recruitment pending), Sweden (authorised, recruitment pending), France (authorised, recruitment pending), Luxembourg (authorised, recruitment pending).
Therapeutic area(s): Diseases [C] - Nervous System Diseases [C10]
Gender: Female, Male. Age: 18-64 years, 65+ years. Enrolment: 110.
Status: Authorised, recruitment pending. Decision date: 2026-06-18. Results received: No. Last updated: 2026-06-22.
Decision dates by country: FR: 2026-06-22, DE: 2026-06-18, IT: 2026-06-18, LU: 2026-06-18, ES: 2026-06-19, SE: 2026-06-22

Condition(s): PARKINSON’S DISEASE
Product: RO7046015, PHYSIOLOGISCHE KOCHSALZLÖSUNG

Primary endpoint: PDCCS
Endpoint(s): Cognitive function measured by MoCA_z., Percentage of participants with diagnosis of PD-MCI defined by MDS Level II criteria., Percentage of participants with diagnosis of PDD., Cognitive function per cognitive domain (at least 2 tests per domain) measured by comprehensive neuropsychological test battery: • Attention and working Memory: TMT A + WAIS IV (LNS) • Executive: Verbal Fluency (animal fluency) + Stroop interference + TMT B • Memory: Hopkins verbal learning test HVLT Delayed Recall + WMS (logical memory) • Visuospatial: Benton’s Judgment of Line Orientation + Hooper Visual Organization Test • Language: Boston naming + WAIS IV (similarities), MDS-UPDRS I-IV (total score and subscores I-IV)., Levodopa-equivalent dosage., Safety outcome measures: ● Safety laboratory tests (hematology, chemistry and coagulation) from baseline over time. ● Incidence of treatment‐emergent abnormal laboratory values and abnormal laboratory values reported as AEs. ● Incidence and severity of AEs. ● Incidence of ADAs. ● ECG assessments from baseline over time; incidence of abnormal ECG assessments., Safety outcome measures: Blood pressure (BP [systolic and diastolic], heart rate, and orthostatic measurement from baseline over time, incidence of abnormal blood pressure [systolic and diastolic], heart rate, and orthostatic changes). ● Incidence of exacerbation of motor and psychiatric side‐effects (including C‐SSRS).

Source: https://euclinicaltrials.eu/ctis-public/view/2024-513496-40-00